EU clinical trial 2024-511159-16-00: Capsaicin in digital osteoarthritis versus control : a randomized study
Protocol code: PHRC IR 2022 MATHIEU
Sponsor: University Hospital Of Clermont-Ferrand (Hospital/Clinic/Other health care facility). Phase: Therapeutic use (Phase IV). Countries: France (ongoing, recruiting).
Therapeutic area(s): Diseases [C] - Musculoskeletal Diseases [C05]
Gender: Female, Male. Age: 18-64 years, 65+ years. Enrolment: 120.
Status: Ongoing, recruiting. Start date (EU): 2025-02-14. Decision date: 2024-05-23. Results received: No. Last updated: 2024-05-23.

Condition(s): digital osteoarthritis
Product: capsaïcine 0.04 %, Qutenza 179 mg cutaneous patch

Primary endpoint: Finger pain intensity at eight weeks (W8) measured on a VAS ranging from 0 to 100 mm.

Source: https://euclinicaltrials.eu/ctis-public/view/2024-511159-16-00